EU clinical trial 2025-522422-13-00: Comparison of Prefilled syringe and Autoinjector presentations of FYB202
Protocol code: FYB202-004
Sponsor: Fresenius Kabi SwissBioSim GmbH (Pharmaceutical company). Phase: Human Pharmacology (Phase I)- Bioequivalence Study. Countries: Poland (ended).
Therapeutic area(s): Diseases [C] - Immune System Diseases [C20]
Gender: Female, Male. Age: 18-64 years. Enrolment: 160.
Status: Ended. Start date (EU): 2025-11-15. End date (EU): 2026-05-18. End date: 2026-05-19. Decision date: 2025-11-03. Results received: No. Last updated: 2026-05-27.

Condition(s): Chronic inflammatory diseases

Source: https://euclinicaltrials.eu/ctis-public/view/2025-522422-13-00